EU clinical trial 2025-523288-39-00: A Phase 2 Randomized, Double-blind, Placebo-Controlled Study to Assess the Safety and Efficacy of MTX-474 in the Treatment of Participants with Diffuse Cutaneous Systemic Sclerosis (dcSSc)
Protocol code: MTX-474-S201
Sponsor: Mediar Therapeutics Inc. (Pharmaceutical company). Phase: Therapeutic exploratory (Phase II). Countries: Netherlands (authorised, recruitment pending), Romania (authorised, recruitment pending), Poland (authorised, recruitment pending), France (not authorised), Italy (authorised, recruitment pending), Spain (authorised, recruitment pending).
Therapeutic area(s): Diseases [C] - Immune System Diseases [C20]
Gender: Female, Male. Age: 18-64 years, 65+ years. Enrolment: 36.
Decision date: 2026-06-29. Results received: No. Last updated: 2026-07-29.
Decision dates by country: FR: 2026-07-06, IT: 2026-07-28, RO: 2026-07-28, ES: 2026-07-28, NL: 2026-06-29, PL: 2026-07-29

Condition(s): Diffuse Cutaneous Systemic Sclerosis (dcSSc)
Product: MTX-474, DEXTROSE/VIOSER 5% w/v Solution for Infusion, NaCl 0,9 % B. Braun, solution pour perfusion

Primary endpoint: Mean change from Baseline to Week 24 on the modified Rodnan skin score (mRSS) in each study arm.
Endpoint(s): Incidence, seriousness, and severity of AEs, TEAEs, SAEs, and treatment-related adverse events (TRAEs), Clinically significant findings on physical examination, vital signs, and clinical laboratory tests., Proportion of participants in each arm with a gene signature response on skin biopsy at Week 12., Sparse and serial PK profiles after MTX-474 administration to participants will be evaluated by population PK, based on drug concentrations in serum over time. For a subset of participants with serial PK sampling, noncompartmental PK parameters (CL, t1/2, and AUCs) will be reported.

Source: https://euclinicaltrials.eu/ctis-public/view/2025-523288-39-00